EU clinical trial 2025-521294-13-00: Post-authorization phase IV low-intervention study to evaluate the efficacy under real-world conditions of the use of LacTEST 0.45 g for the diagnosis of hypolactasia in children aged 5 to 11 years presenting symptoms of lactose intolerance.
Protocol code: VPH-GXL-2025-2
Sponsor: Venter Pharma S.L. (Pharmaceutical company). Phase: Therapeutic use (Phase IV). Countries: Spain (ongoing, recruiting).
Therapeutic area(s): Diseases [C] - Nutritional and Metabolic Diseases [C18]
Gender: Female, Male. Age: 0-17 years. Enrolment: 164.
Status: Ongoing, recruiting. Start date (EU): 2025-07-14. Decision date: 2025-06-19. Results received: No. Last updated: 2026-05-29.

Condition(s): Lactose intolerance
Product: LacTEST 0,45 g polvo para solución oral.

Primary endpoint: Diagnostic performance (sensitivity, specificity, PPV and NPV) of LacTEST 0.45 g in this pediatric population using the proposed cut-off point of 19.18 mg at 5 hours of urine accumulated.
Endpoint(s): Diagnostic performance of different cut-off of Xylose to classify pediatric patients as hypolactasic or normolactasic., Diagnostic performance of shortening urine collection to 4 h using the best cut-off for this test., Number and percentage of AEs and its relationship with LacTEST 0.45 g in this pediatric population.

Source: https://euclinicaltrials.eu/ctis-public/view/2025-521294-13-00